EU clinical trial 2023-510195-31-00: Double-blind, randomised, placebo-controlled, dose-finding phase IIb trial to evaluate the efficacy, safety, and tolerability of a 12-week-treatment with Naronapride in adult participants with at least moderate idiopathic or diabetic gastroparesis
Protocol code: NAT-19/GPX
Sponsor: Dr. Falk Pharma GmbH (Pharmaceutical company). Phase: Therapeutic exploratory (Phase II). Countries: Italy (ended), Austria (ended), Belgium (ended), Netherlands (ended), Germany (ended), Poland (ended), France (ended), Latvia (ended).
Therapeutic area(s): Diseases [C] - Digestive System Diseases [C06]
Gender: Female, Male. Age: 18-64 years, 65+ years. Enrolment: 202.
Status: Ended. Start date (EU): 2023-01-03. End date (EU): 2025-06-19. End date: 2025-09-05. Decision date: 2024-08-01. Results received: No. Last updated: 2025-08-15.
Decision dates by country: NL: 2024-08-05, LV: 2024-08-01, FR: 2024-08-05, IT: 2024-08-12, BE: 2024-08-05, PL: 2024-08-04, AT: 2024-08-22, DE: 2024-08-05

Condition(s): Idiopathic or Diabetic Gastroparesis
Product: NAT01, NAT03, Placebo film coated tablets, NAT02

Primary endpoint: Change of the average weekly total symptom score from BSL (visit 2) to EOT/WD (visit 6)
Endpoint(s): Change of the modified and composite average weekly total symptom score from BSL (visit 2) to EOT/WD (visit 6), Change of the average weekly symptom score for nausea/early satiety/postprandial fullness/upper abdominal pain/number of vomiting episodes/bloating from BSL to EOT/WD

Source: https://euclinicaltrials.eu/ctis-public/view/2023-510195-31-00